EU clinical trial 2023-505875-56-00: The effects of 2-week long treatment with naproxen sodium (Nalgesin® Forte) on synovial fluid cytokine and naproxen concentration and clinical outcomes in patients with knee osteoarthritis – ZOOM-IN: A randomized, double-blind, placebo-controlled, parallel, multicenter clinical trial
Protocol code: KCT23/2022-ZOOM-IN
Sponsor: KRKA tovarna zdravil d.d. Novo mesto (Pharmaceutical company). Phase: Therapeutic use (Phase IV). Countries: Poland (ended).
Therapeutic area(s): Diseases [C] - Musculoskeletal Diseases [C05]
Gender: Female, Male. Age: 18-64 years, 65+ years. Enrolment: 38.
Status: Ended. Start date (EU): 2025-05-21. End date (EU): 2025-09-17. Decision date: 2024-10-21. Results received: Yes. Last updated: 2025-10-21.

Condition(s): Knee osteoarthritis
Product: Paracetamol Biofarm, 500 mg, tabletki, Placebo - Nalgesin forte, Nalgesin Forte, 550 mg, tabletki powlekane

Primary endpoint: Mean change from baseline in IL-6 concentration in SF after 2-week long treatment in study arm with naproxen compared to study arm with placebo.
Endpoint(s): Mean change from baseline in TNF-α concentration in SF after 2-week long treatment in study arm with naproxen compared to study arm with placebo., Mean change from baseline in IL-1β concentration in SF after 2-week long treatment in study arm with naproxen compared to study arm with placebo., Mean change from baseline in pain subscale (P1-P9) KOOS score after 2-week long treatment in study arm with naproxen compared to study arm with placebo., Mean change from baseline in symptoms subscale (S1-S7) KOOS score after 2-week long treatment in study arm with naproxen compared to study arm with placebo., Mean change from baseline in function, daily living subscale (A1-A17) KOOS score after 2-week long treatment in study arm with naproxen compared to study arm with placebo., Mean change from baseline in function, sports and recreational activities subscale (SP1-SP5) KOOS score after 2-week long treatment in study arm with naproxen compared to study arm with placebo., Mean change from baseline in quality of life subscale (Q1-Q4) KOOS score after 2-week long treatment in study arm with naproxen compared to study arm with placebo, Correlation between naproxen concetration in SF and cytokine (IL-1β, IL-6 and TNF-α) concentrations in SF after 2-week long treatment in study arm with naproxen., Correlation between naproxen concentration and pain subscale (P1-P9) KOOS score after 2-week long treatment in study arm with naproxen., Correlation between naproxen concentration in SF and symptoms subscale (S1-S7) KOOS score after 2-week long treatment in study arm with naproxen., Correlation between naproxen concentration in SF and function, daily living subscale (A1-A17) KOOS score after 2-week long treatment in study arm with naproxen., Correlation between naproxen concentration in SF and function, sports and recreational activities subscale (SP1-SP5) KOOS score after 2-week long treatment in study arm with naproxen., Correlation of naproxen concentration in SF and quality of life subscale (Q1-Q4) KOOS score after 2-week long treatment in study arm with naproxen., Determination of synovial membrane penetration index of naproxen after 2-week long treatment in study arm with naproxen.

Source: https://euclinicaltrials.eu/ctis-public/view/2023-505875-56-00